EU clinical trial 2024-514313-35-00: Design and evaluation of an individualized biodrug tapering strategy based on biodrug dosage: the MONITORA study_STEP1
Protocol code: 24CH046
Sponsor: Centre Hospitalier Universitaire De Saint Etienne (Hospital/Clinic/Other health care facility). Phase: Therapeutic use (Phase IV). Countries: France (ongoing, recruiting).
Therapeutic area(s): Diseases [C] - Immune System Diseases [C20]
Gender: Female, Male. Age: 18-64 years, 65+ years. Enrolment: 60.
Status: Ongoing, recruiting. Start date (EU): 2024-12-03. Decision date: 2024-09-20. Results received: No. Last updated: 2025-12-09.

Condition(s): Arthritis rheumatoid
Product: Humira 40 mg solution for injection in pre-filled syringe

Primary endpoint: To assess the primary objective of the study, a regression analysis is necessary to characterize the relationship between i) the risk of RA flare and ii) adalimumab trough concentrations. RA flare-up : 1/ a DAS28 that increase above 2.6 for patient previously in remission (DAS28≤2.6) and a DAS28 increase (∆DAS28) of 0.6 or greater for patients with low disease activity (2.6
Endpoint(s): Presence of anti-adalimumab antibodies will be measured at each visit and at each disease flare. Tolerance will be actively collected at each study visit with an emphasis on any type of infection. All patients will note every infection to a booklet to reduce the memorisation bias.

Source: https://euclinicaltrials.eu/ctis-public/view/2024-514313-35-00